EU clinical trial 2023-509096-16-00: An Interventional Study to Evaluate Treating to a Target of Transmural Healing in Patients with Moderately to Severely Active Crohn’s Disease (VECTORS)
Protocol code: TAK01769
Sponsor: Alimentiv Inc. (Pharmaceutical company). Phase: Therapeutic use (Phase IV). Countries: Germany (ongoing, recruiting), France (ongoing, recruiting), Belgium (ongoing, recruiting), Poland (ongoing, recruiting), Italy (ongoing, recruiting), Netherlands (ongoing, recruiting), Denmark (ongoing, recruiting), Portugal (authorised, recruiting).
Therapeutic area(s): Diseases [C] - Digestive System Diseases [C06]
Gender: Female, Male. Age: 18-64 years, 65+ years. Enrolment: 205.
Start date (EU): 2024-07-31. Decision date: 2024-07-03. Results received: No. Last updated: 2026-07-24.
Decision dates by country: NL: 2024-07-04, DK: 2025-01-13, DE: 2024-07-08, PL: 2024-07-05, FR: 2024-09-11, BE: 2024-07-03, PT: 2026-02-05, IT: 2024-07-04

Condition(s): Moderately to Severely Active Crohn’s Disease
Product: INFLIXIMAB, USTEKINUMAB, PREDNISONE, Entyvio 300 mg powder for concentrate for solution for infusion, BUDESONIDE, UPADACITINIB, ADALIMUMAB, RISANKIZUMAB

Primary endpoint: Corticosteroid-free endoscopic remission at Week 48
Endpoint(s): Corticosteroid-free TMH + endoscopic remission + clinical remission at Week 48; Corticosteroid-free IUS response + endoscopic remission + clinical remission at Week 48; Corticosteroid-free endoscopic remission + clinical remission at Week 48; Corticosteroid-free endoscopic response + clinical response at Week 48, Corticosteroid-free clinical remission at Weeks 14, 22, and 48; Corticosteroid-free clinical response at Weeks 14, 22, and 48; CDAI total score and corresponding change from baseline during follow-up (Weeks 6, 14, 22, 30, 38, and 48), Corticosteroid-free endoscopic response at Week 48; SES-CD total score and corresponding change from baseline to Week 48, TMH at Week 48; IUS response at Week 48; BWT and corresponding change from baseline at Week 48; CDS and corresponding change from baseline at Week 48; International Bowel Ultrasound Segmental Activity Score (IBUS-SAS) (per segment as well as total) and corresponding change from baseline at Week 48, TMH at Weeks 14, 22, 30, 38, and 48; IUS response at Weeks 14, 22, 30, 38, and 48; BWT and corresponding change from baseline at Weeks 14, 22, 30, 38, and 48; CDS and corresponding change from baseline at Weeks 14, 22, 30, 38, and 48; IBUS-SAS and corresponding change from baseline at Weeks 14, 22, 30, 38, and 48, Histologic remission at Week 48; Histologic response at Week 48, Biomarker remission at Week 48; Biomarker response at Week 48; CRP response during follow-up (Weeks 6, 14, 22, 30, 38, and 48); FCal response during follow-up (Weeks 6, 14, 22, 30, 38, and 48); CRP and FCal and their corresponding changes from baseline during follow-up (Weeks 6, 14, 22, 30, 38, and 48), 2-item Patient-Reported Outcome (PRO 2) score, Symptoms and Impacts Questionnaire for CD (SIQ-CD) score, and Urgency Numerical Rating Score (NRS) and their corresponding changes from baseline during follow-up (Weeks 6, 14, 22, 30, 38, and 48); Inflammatory Bowel Disease Questionnaire (IBDQ) score and corresponding changes from baseline during follow-up (Weeks 30 and 48), Time to CD-related complication from randomization through Week 96.; Time to each component of CD-related complication; Switched to an alternate biologic (yes/no) by Week 48 and Week 96; Endpoints related to CDAI, CRP, FCal, and patient-reported measures (as specified above) at Weeks 64, 80, and 96., Exposure-adjusted incidence rates of serious adverse events (SAEs), all adverse events (AEs), and AEs of special interest (AESIs)

Source: https://euclinicaltrials.eu/ctis-public/view/2023-509096-16-00